EU clinical trial 2026-525923-26-00: A Phase 3 Randomized, Double-blind, and Active-controlled, Multicenter Study to Evaluate the Efficacy and Safety of JNJ-78934804 in Participants with Moderately to Severely Active Ulcerative Colitis
Protocol code: 78934804UCO3001
Sponsor: Janssen Cilag International (Pharmaceutical company). Phase: Therapeutic confirmatory (Phase III). Countries: France (authorised, recruitment pending), Slovakia (authorised, recruitment pending), Norway (authorised, recruitment pending), Denmark (authorised, recruitment pending), Greece (authorised, recruitment pending), Italy (authorised, recruitment pending), Netherlands (authorised, recruitment pending), Czechia (authorised, recruitment pending), Germany (authorised, recruitment pending), Belgium (authorised, recruitment pending), Spain (authorised, recruitment pending), Hungary (authorised, recruitment pending), Portugal (authorised, recruitment pending).
Therapeutic area(s): Diseases [C] - Immune System Diseases [C20]
Gender: Female, Male. Age: 18-64 years, 65+ years. Enrolment: 223.
Status: Authorised, recruitment pending. Decision date: 2026-08-03. Results received: No. Last updated: 2026-08-07.
Decision dates by country: BE: 2026-08-05, CZ: 2026-08-04, DK: 2026-08-03, FR: 2026-08-03, DE: 2026-08-07, GR: 2026-08-03, HU: 2026-08-05, IT: 2026-08-06, PT: 2026-08-04, ES: 2026-08-05, NL: 2026-08-03, NO: 2026-08-04, SK: 2026-08-04

Condition(s): Moderately to Severely Active Ulcerative Colitis
Product: JNJ-78934804, Guselkumab

Primary endpoint: Clinical remission at Week 48

Source: https://euclinicaltrials.eu/ctis-public/view/2026-525923-26-00